EU clinical trial 2024-515556-20-00: A Phase 1 Open-Label Mass Balance clinical trial to Investigate the Absorption, Metabolism, and Excretion of Single Oral Administration of [14C]-TEV-56286 Following Multiple Oral Administrations of Nonlabeled TEV-56286 to Healthy Male Participants.
Protocol code: TV56286-MB-10193
Sponsor: Teva Branded Pharmaceutical Products R&D Inc. (Pharmaceutical company). Phase: Human Pharmacology (Phase I)- Other. Countries: Netherlands (ended).
Therapeutic area(s): Diseases [C] - Nervous System Diseases [C10]
Gender: Male. Age: 18-64 years, 65+ years. Enrolment: 8.
Status: Ended. Start date (EU): 2024-10-07. End date (EU): 2024-11-29. Decision date: 2024-10-04. Results received: No. Last updated: 2024-10-04.

Condition(s): Healthy participant

Source: https://euclinicaltrials.eu/ctis-public/view/2024-515556-20-00